EU clinical trial 2022-501606-35-01: 2022-501606-35-00 – Randomized, multicenter, open-label, Phase 3 study of mirvetuximab soravtansine in combination with bevacizumab versus bevacizumab alone as maintenance therapy for patients with FRα-high recurrent platinum-sensitive epithelial ovarian, fallopian tube, or primary peritoneal cancers who have not progressed after second-line platinum-based chemotherapy plus bevacizumab (GLORIOSA).
Protocol code: IMGN853-0421
Sponsor: AbbVie Deutschland GmbH & Co. KG (Pharmaceutical company). Phase: Phase III and phase IV (Integrated). Countries: Belgium (ongoing, recruitment ended), Czechia (ongoing, recruitment ended), Spain (ongoing, recruitment ended), France (ongoing, recruitment ended), Italy (ongoing, recruitment ended), Bulgaria (ended), Germany (ongoing, recruitment ended), Ireland (ongoing, recruitment ended), Hungary (not authorised), Greece (ongoing, recruitment ended), Poland (ongoing, recruitment ended).
Therapeutic area(s): Diseases [C] - Neoplasms [C04]
Gender: Female. Age: 18-64 years, 65+ years. Enrolment: 110.
Start date (EU): 2024-02-21. Decision date: 2023-11-06. Results received: No. Last updated: 2026-03-30.
Decision dates by country: HU: 2024-02-08, IT: 2023-11-10, DE: 2024-02-26, CZ: 2023-11-10, BE: 2023-11-06, BG: 2024-03-11, PL: 2024-03-15, IE: 2024-03-15, GR: 2024-03-21, ES: 2023-11-13, FR: 2023-11-13

Condition(s): Platinum-sensitive epithelial ovarian, fallopian tube, or primary peritoneal cancers
Product: MVASI 25 mg/mL concentrate for solution for infusion, Carboplatin Accord, 10 mg/ml, koncentrat do sporządzania roztworu do infuzji, Bendacitabin 38 mg/ml Pulver zur Herstellung einer Infusionslösung, Alymsys 25mg/mL concentrate for solution for infusion., Pred Forte 1% w/v, Eye Drops Suspension, Carboplatin Accord 10 mg/ml koncentratas infuziniam tirpalui, Zirabev 25 mg/ml concentrate for solution for infusion., PROPYLENE GLYCOL, Paclitaxel Bendalis 6 mg/ml Konzentrat zur Herstellung einer Infusionslösung, Caelyx pegylated liposomal 2 mg/ml concentrate for solution for infusion, Gemcitabin Hikma 38 mg/ml Konzentrat zur Herstellung einer Infusionslösung, Gemcitabin AqVida 38 mg/ml Pulver zur Herstellung einer Infusionslösung, Caelyx pegylated liposomal 2 mg/ml concentrate for solution for infusion, Paclitaxel AqVida 6 mg/ml Konzentrat zur Herstellung einer Infusionslösung, Mirvetuximab Soravtansine, Paclitaxel Ribosepharm 6 mg/ml Konzentrat zur Herstellung einer Infusionslösung, Ribocarbo®-L 10 mg/ml – Konzentrat zur Herstellung einer Infusionslösung

Primary endpoint: PFS, as assessed by BICR per RECIST v1.1, defined as the time from date of randomization until BICR-assessed PD or death due to any cause, whichever occurs first. PFS as assessed by the investigator, as a sensitivity analysis, in the same patient population
Endpoint(s): OS defined as the time from randomization to death due to any cause. Patients alive at the time of analysis will be censored at the last date known to be alive., Treatment-emergent adverse events (TEAEs) and laboratory test results, physical examination (PE) findings, and vital signs, PFS2 as assessed by the investigator, defined as the time from date of randomization until second disease progression or death due to any cause, whichever occurs first, ORR as assessed by the investigator and by BICR in patients who have measurable disease per RECIST v1.1 at randomization, DOR as assessed by the investigator and by BICR in patients who have measurable disease per RECIST v1.1 at randomization and achieved a confirmed response of CR or PR after maintenance therapy, DFS as assessed by the investigator and by BICR in patients who have no measurable disease per RECIST v1.1 at randomization, CA-125 response rate per GCIG criteria, HRQoL/PRO measured by NFOSI-18 DRS-P

Source: https://euclinicaltrials.eu/ctis-public/view/2022-501606-35-01